EU clinical trial 2023-506683-14-00: (Neo)adjuvant IDE196 (Darovasertib) in Patients with Localized Ocular Melanoma
Protocol code: IDE196-009
Sponsor: Ideaya Biosciences Inc. (Pharmaceutical company). Phase: Therapeutic exploratory (Phase II). Countries: Italy (ongoing, recruitment ended), France (ongoing, recruitment ended), Netherlands (ongoing, recruitment ended), Germany (ongoing, recruitment ended).
Therapeutic area(s): Diseases [C] - Eye Diseases [C11]
Gender: Female, Male. Age: 18-64 years, 65+ years. Enrolment: 36.
Status: Ongoing, recruitment ended. Start date (EU): 2024-06-14. Decision date: 2023-12-20. Results received: No. Last updated: 2025-10-20.
Decision dates by country: NL: 2024-01-08, IT: 2023-12-20, FR: 2023-12-21, DE: 2023-12-28

Condition(s): Uveal Melanoma
Product: NORETHISTERONE AND ETHINYLESTRADIOL, IDE196 (LXS196), IDE196 (LXS196), METFORMIN HYDROCHLORIDE

Primary endpoint: The incidence of adverse events (AEs) leading to dose interruption, modification, and discontinuation during neoadjuvant therapy • The incidence of Grade 3 or 4 AEs and clinically significant laboratory abnormalities during neoadjuvant therapy, Cohort 1 – Percentage of patients converted from planned enucleation to eye preserving therapy (e.g., plaque brachytherapy, proton beam radiotherapy, or other) • Cohort 2 –Percentage of patients with a reduction in radiatiAon dose to the fovea, optic disc center, or optic nerve determined by independent central dosimetry modeling, Proportion of subjects with CBR defined as complete response (CR) + partial response (PR) + stable disease (SD) ≥ 12 weeks per the UM response criteria
Endpoint(s): Time from first dose to time of primary local therapy, Tumor response (CR + PR), Decrease in tumor apical height or bidirectional measurements that include the apical height (tumor thickness) and LBD, Loss of ≥ 15 letters by Early Treatment Diabetic Retinopathy Study (ETDRS) Best-Corrected Visual Acuity (BCVA) letter score, Local disease recurrence rate

Source: https://euclinicaltrials.eu/ctis-public/view/2023-506683-14-00